EU clinical trial 2025-524832-20-00: A PHASE 1, OPEN-LABEL STUDY TO ASSESS THE ABSORPTION, DISTRIBUTION, METABOLISM, AND EXCRETION, INCLUDING THE MASS BALANCE, OF A SINGLE ORAL DOSE OF [14C]-VAFIDEMSTAT IN HEALTHY MALE PARTICIPANTS
Protocol code: CL12-ORY-2001
Sponsor: Oryzon Genomics S.A. (Pharmaceutical company). Phase: Human Pharmacology (Phase I)- Other. Countries: Netherlands (ongoing, recruitment ended).
Therapeutic area(s): Not possible to specify
Gender: Male. Age: 18-64 years. Enrolment: 8.
Status: Ongoing, recruitment ended. Start date (EU): 2026-06-01. Decision date: 2026-04-30. Results received: No. Last updated: 2026-07-14.

Condition(s): Healthy volunteers

Source: https://euclinicaltrials.eu/ctis-public/view/2025-524832-20-00